EU clinical trial 2024-518133-28-00: EFFECT OF DEXAMETASONE ON LOWER LIMB EDEMA IN PATIENTS UNDERTAKEN FOR TOTAL HIP ARTHROPLASTY
Protocol code: DXMT
Sponsor: Hospital Universitari De Girona Doctor Josep Trueta (Hospital/Clinic/Other health care facility). Phase: Therapeutic use (Phase IV). Countries: Spain (authorised, recruiting).
Therapeutic area(s): Diseases [C] - Skin and Connective Tissue Diseases [C17]
Gender: Female, Male. Age: 18-64 years, 65+ years. Enrolment: 62.
Status: Authorised, recruiting. Start date (EU): 2025-01-29. Decision date: 2024-10-21. Results received: No. Last updated: 2024-10-21.

Condition(s): POST -OPERATIVE LOWER LIMB EDEMA
Product: SODIUM CHLORIDE, DEXAMETHASONE

Primary endpoint: Thigh circumference • Leg Perimeter • PCR value • IL-6 value
Endpoint(s): sex Age Body mass index Medical history Type of approach Physiotherapy start day Time of admission Postoperative visual analog scale (VAS) • Harris Functional Scale (HHS)

Source: https://euclinicaltrials.eu/ctis-public/view/2024-518133-28-00